EU clinical trial 2024-513301-30-00: Evaluation of the effect of para-sternal block on postoperative respiratory function after sternotomy cardiac surgery. Prospective, controlled, randomized, single-blind study with independent assessment of outcome
Sponsor: Centre Hospitalier Universitaire Amiens Picardie (Hospital/Clinic/Other health care facility). Phase: Therapeutic use (Phase IV). Countries: France (ended).
Therapeutic area(s): Diseases [C] - Cardiovascular Diseases [C14]
Gender: Female, Male. Age: 18-64 years. Enrolment: 84.
Status: Ended. End date (EU): 2024-10-31. Decision date: 2024-05-07. Results received: No. Last updated: 2024-05-07.

Condition(s): cardiac surgery
Product: ROPIVACAINE

Primary endpoint: variation (reduction) in postoperative forced vital capacity (FVC) between preoperative measurement and at D1 post-op. Forced vital capacity is measured by SPIROLAB spirometry SPIROLAB spirometry and is expressed as a % of the theoretical value.
Endpoint(s): Pulmonary function at D2 and 2 months postoperatively. Variables measured included FVC, FEV1, FEV1/FVC, peak expiratory flow (PEF), peak expiratory flow at FVC point 25 (PEF25), PEF50, PEF75, PEF25-75 and PEF75-85., Postoperative pain at 6, 12, 24, 30 and 48 hours will be assessed using a numerical rating scale (EN) graded from 0 to 10. The pain will be classified as "nil" at 0, "mild" from 1 to 3, "moderate" from 4 to 6, "severe" from 7 to 10., During the respiratory physiotherapy session, postoperative pain in the first 48 hours will be assessed using the EN, Daily postoperative pain from day 3 to day 7 will be assessed once between 8 a.m. and 12 p.m. using the EN, The following postoperative pulmonary complications will be detected within 2 months postoperatively and defined according to international criteria (European Perioperative Clinical Outcome definitions): - Respiratory infection (antibiotics in case of suspected suspected infection with one or more of the following: new or modified sputum, pulmonary opacities new or altered, fever fever, white blood cell count >12 × 109.litre-1)., Respiratory failure (postoperative PaO2 <60 mm Hg on room air, PaO2/FiO2 ratio <300 mm Hg, or arterial oxyhemoglobin saturation measured by pulse oximetry <90% and requiring oxygen therapy),, Respiratory failure (postoperative PaO2 <60 mm Hg on room air, PaO2/FiO2 ratio <300 mm Hg, or arterial oxyhemoglobin saturation measured by pulse oximetry <90% and requiring oxygen therapy),, Atelectasis (pulmonary opacification with mediastinal mediastinal displacement, displacement of the hilum or hemidiaphragm towards the affected area, with compensatory hyperinflation in the adjacent lung), Bronchospasm (expiratory wheezing) newly detected and treated with bronchodilators), Duration of mechanical ventilation in hours between arrival to orotracheal extubation, Lung Injury (sRAGE essay), Cumulative consumption of morphine or oxycodone over 48 hours, expressed in milligrams, Length of stay defined in days between admission to hospital discharge., Chronic pain will be assessed at month 2 using the QCD questionnaire (short pain questionnaire)

Source: https://euclinicaltrials.eu/ctis-public/view/2024-513301-30-00